EU clinical trial 2024-518041-16-00: (ROAR) Reversal of opioid-induced respiratory depression with opioid antagonists - a pharmacokinetic pharmacodynamic modeling study in opioid naïve individuals and chronic opioid users under real-life conditions
Sponsor: Leids Universitair Medisch Centrum (LUMC) (Hospital/Clinic/Other health care facility). Phase: Therapeutic use (Phase IV). Countries: Netherlands (ended).
Therapeutic area(s): Phenomena and Processes [G] - Physiological processes [G07]; Phenomena and Processes [G] - Circulatory and Respiratory Physiological Phenomena [G09]
Gender: Female, Male. Age: 18-64 years, 65+ years. Enrolment: 24.
Status: Ended. Start date (EU): 2022-06-15. End date (EU): 2026-03-23. Decision date: 2024-11-15. Results received: No. Last updated: 2024-11-15.

Condition(s): healthy volunteers, opioid use disorder
Product: Fentanyl hameln 50 microgram/ml, oplossing voor injectie, Narcan Nasal Spray, Sufentanil Eurocept 5 microgram/ml, oplossing voor injectie, Zofran 4 Injectie, Naloxon HCl-hameln 0,4 mg/ml, oplossing voor injectie/infusie

Primary endpoint: Our main study measurement is minute ventilation. Together with the plasma concentration of the opioid and naloxone/nalmefene), ventilation is inputted in the PKPD model to get meaningful model parameters such as C50 and t½ke0, measures of potency and the speed of onset/offset of effect, respectively.

Source: https://euclinicaltrials.eu/ctis-public/view/2024-518041-16-00